EU clinical trial 2024-519930-22-00: A Phase II Open-Label Study to Evaluate the Efficacy, Safety, and Pharmacokinetics of Mosunetuzumab in Patients with Systemic Lupus Erythematosus with or without Active Lupus Nephritis
Protocol code: GA45799
Sponsor: F. Hoffmann-La Roche AG (Pharmaceutical company). Phase: Therapeutic exploratory (Phase II). Countries: Italy (ongoing, recruiting).
Therapeutic area(s): Phenomena and Processes [G] - Immune System Phenomena [G13]; Diseases [C] - Immune System Diseases [C20]
Gender: Female, Male. Age: 18-64 years, 65+ years. Enrolment: 5.
Status: Ongoing, recruiting. Start date (EU): 2026-05-18. Decision date: 2025-09-09. Results received: No. Last updated: 2026-05-06.

Condition(s): Systemic Lupus Erythematosus (SLE) With or Without Active Lupus Nephritis (LN)
Product: Mosunetuzumab

Primary endpoint: Achievement of drug-free remission by Week 76
Endpoint(s): Proportion of participants who achieve DORIS remission by Week 76, Proportion of participants who achieve CRR at Weeks 24, 52, 76, and 104, Proportion of participants who achieve PRR at Weeks 24, 52, 76, and 104, Incidence and severity of adverse events, with severity determined according to National Cancer Institute Common Terminology Criteria for Adverse Events, Version 5.0 (NCI CTCAE v5.0) and Cytokine-Release Syndrome (CRS) and immune effector cell-associated neurotoxicity syndrome (ICANS) severity determined according to the 2019 American Society for Transplantation and Cellular Therapy (ASTCT) CRS and ICANS Consensus grading criteria., Change from baseline in targeted vital signs, Change from baseline in targeted clinical laboratory test results, Longitudinal changes in titers of anti-dsDNA and anti-Smith antibodies, Longitudinal changes in complement C3 and C4, Serum concentrations of mosunetuzumab at specified timepoints, Relevant PK parameters of mosunetuzumab, Prevalence of anti-drug antibodies (ADAs) at baseline and incidence of ADAs during the study, B cell levels in the blood (CD19+, absolute counts in blood) at specified timepoints, Change in Functional Assessment of Chronic Illness Therapy (FACIT) – Fatigue from baseline to Week 76, Change in Subject’s Global Assessment of Disease Activity (SGA) from baseline to Week 76

Source: https://euclinicaltrials.eu/ctis-public/view/2024-519930-22-00